EU clinical trial 2024-515166-14-00: BASIC - Botulinum toxin type A blockade of the sphenopalatine ganglion in treatment-refractory chronic cluster headache
Protocol code: BASICstudy
Sponsor: Norwegian University Of Science And Technolology (Educational Institution). Phase: Therapeutic confirmatory (Phase III). Countries: Norway (ongoing, recruiting), Germany (ongoing, recruiting).
Therapeutic area(s): Diseases [C] - Nervous System Diseases [C10]
Gender: Female, Male. Age: 18-64 years, 65+ years. Enrolment: 49.
Status: Ongoing, recruiting. Start date (EU): 2019-11-01. Decision date: 2024-11-07. Results received: No. Last updated: 2025-05-26.
Decision dates by country: DE: 2024-11-08, NO: 2024-11-07

Condition(s): Chronic cluster headache
Product: Natriumklorid B. Braun 9 mg/ml infusjonsvæske, oppløsning, BOTOX 50 Allergan-enheter Pulver til injeksjonsvæske, oppløsning

Primary endpoint: Difference in change from the last 28 day period of the baseline in mean number of cluster headache attacks per week at weeks 5 – 8 post-intervention in the treatment group versus the placebo group.
Endpoint(s): Difference in occurrence of AEs and SAEs in the active group versus the placebo group, Difference in change from baseline week 5-8 in mean number of cluster headache attacks per week during weeks 9-12 post-intervention in the active group versus the placebo group, Difference in change from baseline week 5-8 in mean number of cluster headache attacks per week at weeks 5-8 post-intervention in the active group versus the placebo group, in the prespecified subgroups (cf 8.4.1.2) 3.1. In the high and the low frequency subgroups 3.2. In the high and the low frequency variation subgroups, Difference in change from baseline week 5-8 in mean number of cluster headache attacks per week during weeks 9-12 post-intervention in the active group versus the placebo group, in the prespecified subgroups (cf 8.4.1.2) 4.1. In the high and the low frequency subgroups 4.2. In the high and the low frequency variation subgroups, Difference in the number of therapeutic responders (≥ 30% reduction in attack frequency, intensity or both during weeks 5 – 8 post-intervention compared to baseline) in the active group versus the placebo group. 5.1. In the entire randomized population 5.2. In the high and the low frequency subgroups 5.3. In the high and the low frequency variation subgroups, Difference in the number of attack frequency responders (≥ 30% reduction in attack frequency during weeks 5 – 8 post-intervention compared to baseline). 6.1. In the entire randomized population 6.2. In the high and the low frequency subgroups 6.3. In the high and the low frequency variation subgroups, Difference in change from baseline week 5-8 in mean attack intensity week 5 – 8 post-intervention in the active group versus the placebo group. 7.1. In the entire randomized population 7.2. In the high and the low frequency subgroups 7.3. In the high and the low frequency variation subgroups

Source: https://euclinicaltrials.eu/ctis-public/view/2024-515166-14-00